EU clinical trial 2025-523884-39-00: A double-blind, randomised, placebo-controlled trial evaluating the efficacy and safety of oral nerandomilast treatment in patients with systemic sclerosis (SSc)
Protocol code: 1305-0052
Sponsor: Boehringer Ingelheim International GmbH, Boehringer Ingelheim Espana S.A. (Pharmaceutical company). Phase: Therapeutic confirmatory (Phase III). Countries: Denmark (authorised, recruitment pending), Sweden (authorised, recruitment pending), Netherlands (authorised, recruitment pending), Germany (authorised, recruitment pending), Belgium (authorised, recruitment pending), France (authorised, recruitment pending), Greece (authorised, recruitment pending), Norway (authorised, recruitment pending), Finland (authorised, recruitment pending), Czechia (authorised, recruitment pending), Portugal (authorised, recruitment pending), Bulgaria (authorised, recruitment pending), Estonia (authorised, recruitment pending), Lithuania (authorised, recruitment pending).
Therapeutic area(s): Diseases [C] - Skin and Connective Tissue Diseases [C17]
Gender: Female, Male. Age: 18-64 years, 65+ years. Enrolment: 105.
Status: Authorised, recruitment pending. Decision date: 2026-08-03. Results received: No. Last updated: 2026-08-07.
Decision dates by country: BE: 2026-08-06, BG: 2026-08-07, CZ: 2026-08-05, DK: 2026-08-07, EE: 2026-08-03, FI: 2026-08-05, FR: 2026-08-06, DE: 2026-08-05, GR: 2026-08-03, LT: 2026-08-05, PT: 2026-08-06, SE: 2026-08-03, NL: 2026-08-05, NO: 2026-08-05

Condition(s): Systemic sclerosis
Product: Placebo matching in size, weight, colour, and shape to PRD10855744, BI 1015550, Placebo matching in size, weight, colour, and shape to PRD10442862, BI 1015550

Primary endpoint: Time to the first occurrence of disease progression or all-cause death.
Endpoint(s): Change from baseline in mRSS at Week 52, Change from baseline in HAQ-DI score at Week 52, Change from baseline in FVC [mL] at Week 52, Disease improvement as defined by rCRISS-25 at Week 52, Time to first occurrence of confirmed absolute decline from baseline in FVC % predicted ≥5% (for patients with ILD at baseline) or newly diagnosed ILD (for patients without ILD at baseline) or death, Time to first occurrence of absolute increase in mRSS ≥5 points and relative increase from baseline in mRSS ≥25% or death, Time to first occurrence of adjudicated SSc-related related clinically meaningful disease progression or complication or death, Time to all-cause death, Change from baseline in Systemic Sclerosis Impact of Disease (ScleroID) score at Week 52, Change from baseline in digital ulcer total burden at Week 52

Source: https://euclinicaltrials.eu/ctis-public/view/2025-523884-39-00